EU clinical trial 2023-504403-92-00: A Phase 1, First-in-Human, Dose Escalation Study of the JNJ-75348780 Bispecific Antibody Targeting CD3 and CD22 in Participants with NHL and CLL
Sponsor: Janssen - Cilag International (Pharmaceutical company). Phase: Human Pharmacology (Phase I)- First administration to humans. Countries: Spain (ended), France (ended).
Therapeutic area(s): Diseases [C] - Neoplasms [C04]
Gender: Female, Male. Age: 18-64 years, 65+ years. Enrolment: 60.
Status: Ended. Start date (EU): 2021-02-15. End date (EU): 2025-09-08. End date: 2025-09-09. Decision date: 2024-07-01. Results received: No. Last updated: 2025-02-07.
Decision dates by country: FR: 2024-07-10, ES: 2024-07-01

Condition(s): Relapsed/refractory B-cell Non-Hodgkin Lymphoma (NHL) and Chronic Lymphocytic Leukemia (CLL)

Source: https://euclinicaltrials.eu/ctis-public/view/2023-504403-92-00